EU clinical trial 2023-504028-24-00: A PHASE III, MULTICENTER, RANDOMIZED, OPEN‑LABEL STUDY COMPARING THE EFFICACY AND SAFETY OF GLOFITAMAB (RO7082859) IN COMBINATION WITH POLATUZUMAB VEDOTIN PLUS RITUXIMAB, CYCLOPHOSPHAMIDE, DOXORUBICIN, AND PREDNISONE (POLA-R-CHP) VERSUS POLA‑R‑CHP IN PREVIOUSLY UNTREATED PATIENTS WITH LARGE B-CELL LYMPHOMA
Protocol code: GO44145
Sponsor: F. Hoffmann-La Roche AG (Pharmaceutical company). Phase: Therapeutic confirmatory (Phase III). Countries: Belgium (ongoing, recruitment ended), Denmark (ongoing, recruitment ended), Germany (ongoing, recruitment ended), Poland (ongoing, recruitment ended), France (ongoing, recruitment ended), Spain (ongoing, recruitment ended), Italy (ongoing, recruitment ended).
Therapeutic area(s): Diseases [C] - Neoplasms [C04]
Gender: Female, Male. Age: 18-64 years, 65+ years. Enrolment: 403.
Status: Ongoing, recruitment ended. Start date (EU): 2023-09-22. Decision date: 2023-08-28. Results received: No. Last updated: 2026-06-03.
Decision dates by country: IT: 2023-08-28, ES: 2023-08-30, DE: 2023-09-01, DK: 2023-08-28, PL: 2023-09-04, BE: 2023-08-28, FR: 2023-08-29

Condition(s): Large B-Cell Lymphoma

Primary endpoint: PFS, as determined by the IRF
Endpoint(s): PFS, as determined by the investigator, EFSeff, CR rate at the end of treatment by FDG-PET, ORR at treatment completion or discontinuation, OS, DOR, DOCR, DFS, PFS in participants with IPI score 3-5, Incidence and severity of adverse events, with severity determined according to the national cancer institute common terminology criteria for adverse events version 5.0 (NCI CTCAE v5.0) grading scale, including cytokine release syndrome (CRS), with severity determined according to the american society for transplantation and cellular therapy (ASTCT) CRS grading criteria (Lee et al. 2019), Change from baseline in targeted vital signs, Change from baseline in targeted clinical laboratory test results, Tolerability, as assessed by dose interruptions, dose reductions, and dose intensity, and study treatment discontinuation because of adverse events, Serum concentration of glofitamab at specified timepoints, Prevalence of anti-drug antibodies (ADAs) of glofitamab at baseline and incidence of ADAs during the study and follow up period, Proportion of participants experiencing a clinically meaningful improvement in physical functioning and fatigue [european organisation for research and treatment of cancer quality of life questionnaire (EORTC QLQ-C30)], and lymphoma symptoms [functional assessment of cancer therapy lymphoma subscale (FACT Lym LymS)], Proportion of participants experiencing a clinically meaningful improvement in fatigue (EORTC QLQ-C30), Proportion of participants experiencing a clinically meaningful improvement in lymphoma symptoms (FACT-Lym LymS), Time to deterioration in physical functioning and fatigue (EORTC QLQ-C30), and lymphoma symptoms (FACT-Lym LymS), Time to deterioration in fatigue (EORTC QLQ-C30), Time to deterioration in lymphoma symptoms (FACT-Lym LymS)

Source: https://euclinicaltrials.eu/ctis-public/view/2023-504028-24-00